EU clinical trial 2025-522534-31-00: A single dose, randomized, double-blind 2-arm parallel-group study to compare the pharmacokinetics, immunogenicity, and safety for PB016 versus US-licensed Entyvio® after subcutaneous administration in healthy participants
Protocol code: PB016-01-02
Sponsor: Polpharma Biologics S.A. (Pharmaceutical company). Phase: Human Pharmacology (Phase I)- Other. Countries: Germany (ongoing, recruitment ended).
Therapeutic area(s): Not possible to specify
Gender: Female, Male. Age: 18-64 years. Enrolment: 132.
Status: Ongoing, recruitment ended. Start date (EU): 2026-01-27. Decision date: 2025-11-13. Results received: No. Last updated: 2026-04-07.

Condition(s): Not applicable, healthy volunteers

Source: https://euclinicaltrials.eu/ctis-public/view/2025-522534-31-00